EU clinical trial 2024-515177-94-00: A 17-week, Phase 2, Randomized, Double-blind, Placebo-controlled, Flexible-dosing, Parallel-group, Multicenter Study of the Efficacy and Safety of Suvecaltamide in the Treatment of Moderate to Severe Residual Tremor in Participants with Parkinson’s Disease
Protocol code: JZP385-202-01
Sponsor: Cavion Inc. (Pharmaceutical company). Phase: Therapeutic exploratory (Phase II). Countries: Spain (ended), Germany (ended), Poland (ended).
Therapeutic area(s): Diseases [C] - Nervous System Diseases [C10]
Gender: Female, Male. Age: 18-64 years, 65+ years. Enrolment: 132.
Status: Ended. Start date (EU): 2023-06-21. End date (EU): 2024-11-01. End date: 2024-11-11. Decision date: 2024-10-10. Results received: Yes. Last updated: 2024-11-27.
Decision dates by country: ES: 2024-10-10, PL: 2024-10-16, DE: 2024-11-27

Condition(s): Parkinson's Disease
Product: Placebo comprised of microcrystalline cellulose, used in JZP385-202-MCC placebo in the IMPD., JZP385, JZP385

Primary endpoint: Evaluate the efficacy of suvecaltamide administered once daily for 17 weeks to improve functional and performance-based impairment due to tremor
Endpoint(s): Efficacy: Evaluate the efficacy of suvecaltamide administered once daily for 17 weeks to improve functional impairment due to tremor Safety: Incidence and severity of AEs as well as evaluation of safety laboratory assessments, vital signs, ECG results, C- SSRS and QUIP-RS

Source: https://euclinicaltrials.eu/ctis-public/view/2024-515177-94-00